EU clinical trial 2025-524620-22-00: A 2-part phase 1/2 open-label trial evaluating the safety, tolerability, pharmacokinetics, pharmacodynamics, and efficacy of ODM-212 in combination with anti-cancer therapy in participants with advanced solid tumours
Protocol code: 3134003
Sponsor: Orion Corporation (Pharmaceutical company). Phase: Phase I and Phase II (Integrated)- Other. Countries: Finland (authorised, recruitment pending), Denmark (authorised, recruiting), Spain (ongoing, recruiting), France (ongoing, recruiting).
Therapeutic area(s): Diseases [C] - Neoplasms [C04]
Gender: Female, Male. Age: 18-64 years, 65+ years. Enrolment: 85.
Start date (EU): 2026-06-22. Decision date: 2026-05-22. Results received: No. Last updated: 2026-07-27.
Decision dates by country: DK: 2026-05-29, FI: 2026-05-22, ES: 2026-05-27, FR: 2026-05-28

Condition(s): Neoplasms benign malignant and unspecified (incl. cysts and polyps)
Product: NIVOLUMAB, IPILIMUMAB, SOTORASIB, ODM-212 40 mg coated tablet , PACLITAXEL ALBUMIN-BOUND, ODM-212 5 mg coated tablet, GEMCITABINE

Primary endpoint: Part 1: Incidence of dose-limiting toxicities (DLTs), treatment-emergent adverse events (TEAEs), serious adverse events (SAEs) and clinical laboratory abnormalities (incl. electrocardiogram [ECG])., Part 2: Incidence of TEAEs, SAEs and clinical laboratory abnormalities (incl. ECG).
Endpoint(s): Part 1: Efficacy evaluations: objective response rate (ORR), duration of response (DOR), disease control rate (DCR), progression-free survival (PFS) and duration of stable disease will be determined based on Response Evaluation Criteria in Solid Tumors (RECIST) version 1.1, Part 1: ODM-212 concentrations and pharmacokinetic (PK) variables (including but not limited to Cmax, AUCt, AUC0-24) on the last day of cycle 1 or 2, Part 2: ORR, per RECIST 1.1, DOR, DCR, clinical benefit rate (CBR), PFS and overall survival (OS)., Part 2: Dose selection based on safety, exposure, and all other available nonclinical, clinical, PK and biomarker data., Part 2: ODM-212 concentrations and PK variables (including but not limited to Cmax, AUCt, AUC0-24) on the last day of cycle 1.

Source: https://euclinicaltrials.eu/ctis-public/view/2025-524620-22-00